EU clinical trial 2024-513546-11-00: A Phase II, Open-Label, Multi-Center Study to Compare the Pharmacokinetics of Tacrolimus in Stable Pediatric Allograft Recipients Converted from a Prograf® Based Immunosuppressive Regimen to a Tacrolimus Prolonged Release, Advagraf® Based Immunosuppressive Regimen, Including a Long-Term Follow Up
Protocol code: PMR-EC-1206
Sponsor: Astellas Pharma Europe Limited (Pharmaceutical company). Phase: Therapeutic exploratory (Phase II). Countries: Czechia (ended).
Therapeutic area(s): Analytical,Diagnostic,Therapeutic Techniques and Equipment [E]-Surgical Procedures, Operative [E04]
Gender: Female, Male. Age: 0-17 years. Enrolment: 13.
Status: Ended. Start date (EU): 2014-03-10. End date (EU): 2025-11-03. End date: 2025-11-04. Decision date: 2024-06-28. Results received: Yes. Last updated: 2025-06-12.

Condition(s): Prophylaxis of primary liver, kidney, heart, lung, and intestinal organ transplant rejection
Product: Advagraf 0.5 mg prolonged-release hard capsules, Advagraf 1 mg prolonged-release hard capsules, Advagraf 1 mg prolonged-release hard capsules, Advagraf 5 mg prolonged-release hard capsules, Advagraf 1 mg prolonged-release hard capsules, Advagraf 0.5 mg prolonged-release hard capsules, Advagraf 0.5 mg prolonged-release hard capsules, Advagraf 1 mg prolonged-release hard capsules, Advagraf 0.5 mg prolonged-release hard capsules, Advagraf 1 mg prolonged-release hard capsules, Advagraf 0.5 mg prolonged-release hard capsules, Advagraf 3 mg prolonged-release hard capsules, Advagraf 3 mg prolonged-release hard capsules, Advagraf 5 mg prolonged-release hard capsules, Advagraf 3 mg prolonged-release hard capsules, Advagraf 1 mg prolonged-release hard capsules, Advagraf 1 mg prolonged-release hard capsules, Advagraf 0.5 mg prolonged-release hard capsules, Advagraf 5 mg prolonged-release hard capsules, Advagraf 3 mg prolonged-release hard capsules, Advagraf 5 mg prolonged-release hard capsules, Advagraf 3 mg prolonged-release hard capsules, Advagraf 5 mg prolonged-release hard capsules, Advagraf 3 mg prolonged-release hard capsules, Advagraf 1 mg prolonged-release hard capsules, Advagraf 5 mg prolonged-release hard capsules

Primary endpoint: The steady state systemic exposure (AUC0-24h) of tacrolimus when administered as Advagraf® or Prograf® in stable pediatric allograft recipients.
Endpoint(s): Secondary pharmacokinetic variables: Cmax; tmax; C24, Safety: Incidence of adverse events; Laboratory parameters; Vital signs, Efficacy: Rejection episodes; Subject and graft survival

Source: https://euclinicaltrials.eu/ctis-public/view/2024-513546-11-00